EU clinical trial 2025-521806-16-00: Single-centre, randomised, double-blind, split-face comparative design clinical trial to evaluate the efficacy and safety of the topical formulation with 4% hydroquinone and 0,025% tretinoin versus the formulation with 4% hydroquinone in patients with facial melasma
Protocol code: MED-004-EC-25
Sponsor: Mesoestetic Pharma Group S.L. (Pharmaceutical company). Phase: Phase I and Phase II (Integrated)- First administration to humans. Countries: Spain (authorised, recruitment pending).
Therapeutic area(s): Diseases [C] - Skin and Connective Tissue Diseases [C17]
Gender: Female. Age: 18-64 years. Enrolment: 21.
Status: Authorised, recruitment pending. Decision date: 2026-05-05. Results received: No. Last updated: 2026-06-12.

Condition(s): facial melasma

Source: https://euclinicaltrials.eu/ctis-public/view/2025-521806-16-00